EU clinical trial 2025-522106-20-00: A double blinded, balanced, randomized, two-treatment, four-period, two-sequence, single-dose, crossover fully replicate bioequivalence study comparing Mesalamine Delayed Release Tablets USP 1.2 g manufactured by Sun Pharmaceutical Industries Limited, India with Mezavant (mesalamine) Delayed and Extended-Release Tablets 1.2 g product of Takeda Canada Inc., in healthy, adult, human subjects under fasting condition.
Protocol code: MESAL-03-25
Sponsor: Sun Pharmaceutical Industries Limited (Pharmaceutical company). Phase: Human Pharmacology (Phase I)- Bioequivalence Study. Countries: Romania (authorised, recruitment pending).
Therapeutic area(s): Diseases [C] - Digestive System Diseases [C06]
Gender: Female, Male. Age: 18-64 years. Enrolment: 112.
Status: Authorised, recruitment pending. Decision date: 2025-09-01. Results received: No. Last updated: 2025-09-01.

Condition(s): ulcerative colitis

Source: https://euclinicaltrials.eu/ctis-public/view/2025-522106-20-00